EU clinical trial 2024-520308-24-00: BASECOVID - Bevacizumab in post-acute sequelae of COVID-19 : Efficacy and Safety (Pilot Study)
Protocol code: APHP241020
Sponsor: Assistance Publique Hopitaux De Paris (Hospital/Clinic/Other health care facility). Phase: Therapeutic exploratory (Phase II). Countries: France (authorised, recruitment pending).
Therapeutic area(s): Diseases [C] - Virus Diseases [C02]
Gender: Female, Male. Age: 18-64 years, 65+ years. Enrolment: 21.
Status: Authorised, recruitment pending. Decision date: 2025-10-24. Results received: No. Last updated: 2025-10-29.

Condition(s): Adult patients with persistent dyspnea more than 3 months after acute COVID-19 infection.
Product: BEVACIZUMAB

Primary endpoint: The primary endpoint is defined as the rate of patients with 10% increase of impaired DLCO within the 3 months after the introduction of bevacizumab.
Endpoint(s): 1- Description of clinical symptoms at 1, 2, 3 and 7 months after the initiation of bevacizumab treatment in particular mMRC Scale, Borg Scale, STOP-BANG Questionnaire, WHODAS 2.0, Epworth Sleepiness Scale, which assess fatigue severity in long-COVID patients., 2- Description of psychological, cognitive, and autonomic functions at 3 and 7 months after the initiation of Bevacizumab treatment. In particular, additional assessments will be conducted to evaluate psychological, cognitive, and autonomic functions with the Nijmegen Questionnaire, the Hospital Anxiety and Depression Scale, the Montreal Cognitive Assessment, the self-reported Ricci-Gagnon Physical Activity Questionnaire, the Somatic Symptom Disorder Scale-12 (SSD-12) an, 3- Description of other parameter than DLCO explored by Pulmonary Function Test evaluated at 1, 2, 3 and 7 months after the initiation of Bevacizumab treatment. Difference of FEV1, FVC, FEV1/FVC ratio, TLC, RV and 6 minute walking distance between baseline and 1, 2, 3 and 7 months and the difference of DLCO between baseline and 1and 2 months., 4- Difference of circulating angiogenic biomarkers levels between baseline and 1, 2, 3 and 7 months after the initiation of Bevacizumab treatment., 5- Number of side effects related to bevacizumab and proportion of patients with hospitalization or medical consultation during the 7 months after the start of the treatment.

Source: https://euclinicaltrials.eu/ctis-public/view/2024-520308-24-00